EU clinical trial 2024-515064-31-00: Use of nivolumab (N) followed by chemotherapy: bendamustine, gemcitabine and dexamethasone (BGD) with autologous bone marrow transplantation in patients with Hodgkin’s lymphoma refractory to 1-line therapy.
Protocol code: NBK132/2/2021
Sponsor: Medical University Of Gdansk (Educational Institution). Phase: Therapeutic exploratory (Phase II). Countries: Poland (ongoing, recruiting).
Therapeutic area(s): Diseases [C] - Hemic and Lymphatic Diseases [C15]
Gender: Female, Male. Age: 18-64 years, 65+ years. Enrolment: 84.
Status: Ongoing, recruiting. Start date (EU): 2022-12-01. Decision date: 2024-11-05. Results received: No. Last updated: 2024-11-05.

Condition(s): Refractory / relapsed Hodgkin's lymphoma
Product: NIVOLUMAB

Primary endpoint: Complete Metabolic Remission (CMR) rate after 2 cycles of BGD preceded by 3 administrations of Nivolumab (N)., PFS, which is the time from N treatment initiation to progression (PD) or death, regardless of cause.
Endpoint(s): Percentage of all complete and partial metabolic responses (overall metabolic response rate, OMRR = CMR + CSF after N, BGD, and aHCT treatment., Overall Survival (OS) from the time of initiation of Nivolumab treatment to the time of death from any cause., Percentage of patients among whom aHCT was successfully performed., Tolerance of N-BGD treatment defined as the frequency of adverse events (AEs) with a toxicity level greater than two based on Common Terminology Criteria for Adverse Events (CTCAE) Version 5.0., The number of grade 3 and 4 adverse reactions assessed according to CTCAE v. 5.

Source: https://euclinicaltrials.eu/ctis-public/view/2024-515064-31-00